EU clinical trial 2023-508517-16-00: A Phase 1/2, Open-label, Dose-escalation, and Dose-expansion Study Evaluating the Safety, Tolerability, Pharmacokinetics, Pharmacodynamics, and Preliminary Efficacy of D3S-001 Monotherapy or Combination Therapy in Subjects with Advanced Solid Tumors with a KRAS p.G12C Mutation"
Protocol code: D3S-001-100
Sponsor: D3 Bio (Wuxi) Co. Ltd. (Pharmaceutical company). Phase: Phase I and Phase II (Integrated)- First administration to humans. Countries: Italy (ongoing, recruiting), Germany (ongoing, recruiting), Spain (ongoing, recruiting), France (ongoing, recruiting).
Therapeutic area(s): Diseases [C] - Neoplasms [C04]
Gender: Female, Male. Age: 18-64 years, 65+ years. Enrolment: 95.
Status: Ongoing, recruiting. Start date (EU): 2024-11-10. Decision date: 2024-04-05. Results received: No. Last updated: 2025-09-24.
Decision dates by country: DE: 2024-05-15, IT: 2024-05-20, ES: 2024-04-12, FR: 2024-04-05

Condition(s): Advanced Solid Tumors with a KRAS p.G12C Mutation
Product: Erbitux 5 mg/mL solution for infusion, Erbitux 5 mg/mL solution for infusion, CISPLATIN, PEMETREXED, D3S-001, D3S-001, KEYTRUDA 25 mg/mL concentrate for solution for infusion, CARBOPLATIN

Primary endpoint: Treatment-emergent AEs, treatment-related Aes, Clinically significant changes in vital signs, physical examinations, ECGs, and clinical laboratory test, The MTD, if applicable, will be based on DLTs, The RP2D in the expansion part will be based on emerging data
Endpoint(s): PK parameters of D3S-001 including, but not limited to: Cmax, tmax, t1/2, and AUC, PK parameters of D3S-001 including, but not limited to: Cmax, tmax, t1/2, and AUC in the fed versus. fasted states for the food effect assessment, ORR, DOR, DCR, DCR at 24 weeks (CR, PR, or SD ≥24 weeks), and PFS as assessed per RECIST v1.1 by investigators and BICR

Source: https://euclinicaltrials.eu/ctis-public/view/2023-508517-16-00